EU clinical trial 2022-502789-26-01: A Phase 2a, Randomized, Placebo-controlled, Double-blind Study to Assess the Safety, Pharmacokinetics, and Pharmacodynamics of AGMB-129 in Patients with Fibrostenotic Crohn’s Disease
Protocol code: AGMB-129-C102
Sponsor: Agomab Spain S.L.U. (Pharmaceutical company). Phase: Therapeutic exploratory (Phase II). Countries: Germany (ended), Italy (ended), Spain (ended), Poland (ended), Denmark (ended), Austria (ended).
Therapeutic area(s): Diseases [C] - Digestive System Diseases [C06]
Gender: Female, Male. Age: 18-64 years, 65+ years. Enrolment: 63.
Status: Ended. Start date (EU): 2023-11-03. End date (EU): 2026-06-19. End date: 2026-06-20. Decision date: 2023-10-09. Results received: No. Last updated: 2026-05-08.
Decision dates by country: IT: 2023-10-11, DK: 2023-10-10, ES: 2023-10-09, DE: 2023-10-11, PL: 2023-10-16, AT: 2023-10-16

Condition(s): Fibrostenotic Crohn’s Disease
Product: ORG-129, Placebo to IMP AGMB-129

Primary endpoint: Adverse events (AEs), Clinical laboratory tests, Electrocardiogram (ECG) findings, Vital signs, Physical examination findings, 2-D echocardiogram findings
Endpoint(s): PK parameters of AGMB-129 and its metabolites in plasma (Part A and Part B), Change in gene expression at the mRNA level in ileal mucosa (Part A)

Source: https://euclinicaltrials.eu/ctis-public/view/2022-502789-26-01